EU clinical trial 2024-512687-66-00: A Phase 1b, Open-Label Study of the Safety, Pharmacokinetics, and Pharmacodynamics of JNJ-64264681 in Combination with JNJ-67856633 in Participants with Non-Hodgkin Lymphoma and Chronic Lymphocytic Leukemia
Protocol code: 64264681LYM1002
Sponsor: Janssen Cilag International (Pharmaceutical company). Phase: Human Pharmacology (Phase I)- Other. Countries: Poland (ended), Belgium (ended).
Therapeutic area(s): Diseases [C] - Neoplasms [C04]
Gender: Female, Male. Age: 18-64 years, 65+ years. Enrolment: 33.
Status: Ended. Start date (EU): 2021-02-16. End date (EU): 2025-01-15. End date: 2025-01-16. Decision date: 2024-08-20. Results received: No. Last updated: 2024-08-26.
Decision dates by country: BE: 2024-08-20, PL: 2024-08-26

Condition(s): non-Hodgkin lymphoma and chronic lymphocytic leukemia

Source: https://euclinicaltrials.eu/ctis-public/view/2024-512687-66-00